EU clinical trial 2024-511513-37-00: Comparison of isotonic saline and Ringer lactate in the management of severe diabetic ketoacidosis: a double-blind randomized controlled trial.
Protocol code: 22-API-03
Sponsor: Centre Hospitalier Universitaire De Nice (Hospital/Clinic/Other health care facility). Phase: Therapeutic use (Phase IV). Countries: France (ongoing, recruiting).
Therapeutic area(s): Diseases [C] - Nutritional and Metabolic Diseases [C18]
Gender: Female, Male. Age: 18-64 years, 65+ years. Enrolment: 300.
Status: Ongoing, recruiting. Start date (EU): 2025-10-23. Decision date: 2025-01-10. Results received: No. Last updated: 2026-06-05.

Condition(s): Diabetic keto-acidosis
Product: SODIUM CHLORIDE, SODIUM LACTATE

Primary endpoint: Resolution of ketoacidosis allowing discharge from randomization (i.e. start of the investigational medicinal product administration), defined as the proportion of patients with the following three criteria at 24 hours from randomization (i.e. start of the investigational medicinal product administration) : 1. capillary or blood glucose < 11 mmol/L 2. undetectable ketonemia or ketonuria 3. venous or arterial pH > 7.35 or venous or arterial bicarbonate > 20 mmol/L

Source: https://euclinicaltrials.eu/ctis-public/view/2024-511513-37-00